EU clinical trial 2024-516211-25-00: A follow-up study evaluating the long term safety of autologous CD34+-enriched hematopoietic progenitor cells genetically modified with a lentiviral vector encoding for the human interferon-α2 gene previously administered to patients with glioblastoma multiforme
Protocol code: TEM-LT
Sponsor: Genenta Science S.p.A. (Pharmaceutical company). Phase: Phase I and Phase II (Integrated)- Other. Countries: Italy (ongoing, recruiting).
Therapeutic area(s): Diseases [C] - Neoplasms [C04]
Gender: Female, Male. Age: 18-64 years, 65+ years. Enrolment: 5.
Status: Ongoing, recruiting. Start date (EU): 2022-10-27. Decision date: 2024-08-26. Results received: No. Last updated: 2024-08-26.

Condition(s): Glioblastoma multiforme (GBM)
Product: TEMFERON

Primary endpoint: The primary endpoint is to assess the mutagenic potential of Temferon following administration (the first two years of the monitoring are included in the TEM-GBM_001 study), as evaluated by the incidence of hematopoietic malignancies or potentially life threatening, malignant solid or other hematological tumors.
Endpoint(s): Safety: the incidence of increasingly expanding clone of peripheral white blood cells., Safety: Long-term tolerability and safety of Temferon following Temferon administration, evaluated by: - routine clinical and laboratory surveillance; - development or exacerbation of non-GBM related neurologic disorders attributed to Temferon exposure; - development or exacerbation of hematologic disorders, rheumatologic disorders, autoimmune manifestations attributed to Temferon exposure; - development of infections that are attributed to Temferon exposure., Efficacy: identify myeloid cells in peripheral blood (PB), Efficacy: determine the proportions of patients achieving complete response (CR), partial response (PR), stable disease (SD), and progressive disease (PD) using standard iRANO criteria., Efficacy: Overall Survival (OS) will be calculated from the first day following Temferon administration.

Source: https://euclinicaltrials.eu/ctis-public/view/2024-516211-25-00